EU clinical trial 2024-516010-38-00: A Phase 1 First-in-Human Study of the Safety and Effects of VIR-5818 Alone or with Pembrolizumab in Participants with Advanced or Metastatic HER2-Expressing Cancers
Protocol code: VIR-5818-V101
Sponsor: Vir Biotechnology Inc. (Pharmaceutical company). Phase: Human Pharmacology (Phase I)- First administration to humans. Countries: Spain (ongoing, recruiting), France (ongoing, recruiting), Portugal (ongoing, recruiting).
Therapeutic area(s): Diseases [C] - Neoplasms [C04]
Gender: Female, Male. Age: 18-64 years, 65+ years. Enrolment: 240.
Status: Ongoing, recruiting. Start date (EU): 2022-04-25. Decision date: 2024-08-27. Results received: No. Last updated: 2026-07-15.
Decision dates by country: PT: 2024-09-12, ES: 2024-08-27, FR: 2024-09-05

Condition(s): Participants with Locally Advanced or Metastatic HER2-Expressing Cancers

Source: https://euclinicaltrials.eu/ctis-public/view/2024-516010-38-00